EU clinical trial 2024-514633-38-00: Comparison of azathioprine to methotrexate in combination therapy with adalimumab in Crohn’s Disease: an open-label randomized controlled trial
Sponsor: Centre Hospitalier Universitaire Amiens Picardie (Hospital/Clinic/Other health care facility). Phase: Therapeutic confirmatory (Phase III). Countries: France (authorised, recruitment pending).
Therapeutic area(s): Diseases [C] - Digestive System Diseases [C06]
Gender: Female, Male. Age: 18-64 years, 65+ years. Enrolment: 166.
Status: Authorised, recruitment pending. Decision date: 2024-08-20. Results received: No. Last updated: 2025-10-15.

Condition(s): Crohn’s Disease
Product: METOJECT 25 mg/0,5 ml, solution injectable en seringue préremplie, Humira 20 mg solution for injection in pre-filled syringe, IMUREL 25 mg, comprimé pelliculé

Primary endpoint: Endoscopic response defined as a decrease of at least 50% of the SES-CD at week W26 as compared to baseline
Endpoint(s): Clinical response at each visit, Clinical remission at each visit, Corticosteroid-free clinical remission at W12, W26, W52, W78 and W104, Necessity of adalimumab optimization during follow-up, AZA, MTX and adalimumab withdrawal during follow-up, Trough serum levels and antibodies to adalimumab at W12-W26, W52, W78 and W104, Change in IBD-Q and change in IBD-Disability index between W0 and W12, W26, W52, W78 and W104, Change in C-reactive protein (CRP) level between W0, W12, W26, W52, W78 and W104, Change in Calprotectin level between W0, W12, W26, W52, W78 and W104, Endoscopic remission (SES-CD< 3) and ulcer free endoscopy at W26, Deep remission at W26, CD-related hospitalization during follow-up, CD-related surgery during follow-up, Occurrence of adverse events

Source: https://euclinicaltrials.eu/ctis-public/view/2024-514633-38-00